EU clinical trial 2025-522961-31-01: The Acute and Long-term Impact of Support in Psilocybin Therapy for Depression: The Psilocybin Setting Trial (PSISET)
Sponsor: Kobenhavns Universitet, Koebenhavns Universitet (Educational Institution). Phase: Therapeutic exploratory (Phase II). Countries: Denmark (authorised, recruitment pending).
Therapeutic area(s): Psychiatry and Psychology [F] - Mental Disorders [F03]
Gender: Female, Male. Age: 18-64 years, 65+ years. Enrolment: 180.
Status: Authorised, recruitment pending. Decision date: 2026-07-03. Results received: No. Last updated: 2026-07-03.

Condition(s): Depression
Product: PEX010 Psilocybin Capsules ( 25mg psilocybin)

Primary endpoint: Between group differences (psychotherapy vs basic support) in MADRS score change from baseline to Week 10, Between group differences (psychotherapy vs SoC) in MADRS score change from baseline to Week 10
Endpoint(s): Between group differences (psychotherapy vs basic support and psychotherapy vs SoC)) in proportion of participants achieving ≥50% re duction in MADRS and remission (MADRS ≤10) at Week 10, 26, and 52, Between group differences in changes in MADRS-S, MDI, GAD-7, PHQ, WHOQOL-BREF, SWLS, MPFI, ECR-SF, TEQ and PSQI from base line to follow-ups, Correlation between measures of psychothera peutic mechanisms (WAI-SR, PBAT, qualitative interviews), and changes in treatment out comes, Correlation between measures of the psyche delic experience (MEQ30, 5D-ASC, EBI, CEQ, PMQ-SF, SDI-A, PEQ, qualitative interviews) and changes in treatments outcomes, Correlation between blood biomarkers (e.g., BDNF, inflammatory markers) and changes in treatment outcomes, Assessment of psychotic symptoms, suicidality, worsening of depressive symptoms and adverse events at follow-ups

Source: https://euclinicaltrials.eu/ctis-public/view/2025-522961-31-01